EU clinical trial 2025-523091-23-00: ZANUBRUTINIB, A SECOND GENERATION BTK INHIBITOR, IN ANTI-MAG ANTIBODY NEUROPATHY: A PHASE II ITALIAN MULTICENTER CLINICAL TRIAL (MAZINGA)
Protocol code: MAZ-01
Sponsor: Azienda Ospedaliera di Padova (Hospital/Clinic/Other health care facility). Phase: Therapeutic exploratory (Phase II). Countries: Italy (ongoing, recruiting).
Therapeutic area(s): Diseases [C] - Nervous System Diseases [C10]; Diseases [C] - Hemic and Lymphatic Diseases [C15]
Gender: Female, Male. Age: 18-64 years, 65+ years. Enrolment: 50.
Status: Ongoing, recruiting. Start date (EU): 2026-03-24. Decision date: 2025-12-10. Results received: No. Last updated: 2026-04-03.

Condition(s): Peripheral anti-MAG neuropathy, waldenstrom macroglobulinemia, marginal zone lymphoma, chronic lymphocytic leukemia, monoclonal gammopathy of unknown significance
Product: BRUKINSA 80 mg hard capsules, Zanubrutinib

Primary endpoint: The proportion of patients with neurological improvement defined as improvement of at least 1 point in at least 2 neurological scales (ONLS, INCAT disability, INCAT sensory sum scores (ISS), MRC sum score, I-RODS functional score) at 12 months of zanubrutinib treatment.
Endpoint(s): ● The proportion of patients with neurological improvement after 24 and 48 months of zanubrutinib; ● the proportion of patients with ENG/EMG improvement since the baseline, assessing decrease of distal motor latency, increase of terminal latency index, increase of sensory nerve action potential amplitude (see criteria of evaluation) at upper limbs after zanubrutinib treatment at 12, 24 and 48 months; ● levels of monoclonal protein, IgM and of anti-MAG antibody titers at 12, 24 and 48 months.

Source: https://euclinicaltrials.eu/ctis-public/view/2025-523091-23-00